EU clinical trial 2025-522029-37-00: A Phase III, Multicentre, Open-Label, Randomised Study Evaluating the Efficacy and Safety of R-mini-CHOP x2 followed by AZD0486 versus R-mini-CHOP x6 in Elderly or Unfit Participants with Newly Diagnosed Large B-cell Lymphoma (SOUNDTRACK-D2)
Protocol code: D7402C00001
Sponsor: AstraZeneca AB (Pharmaceutical company). Phase: Therapeutic confirmatory (Phase III). Countries: Poland (ongoing, recruiting), Belgium (ongoing, recruiting).
Therapeutic area(s): Diseases [C] - Neoplasms [C04]
Gender: Female, Male. Age: 65+ years. Enrolment: 30.
Status: Ongoing, recruiting. Start date (EU): 2026-02-27. Decision date: 2026-01-30. Results received: No. Last updated: 2026-04-22.
Decision dates by country: PL: 2026-02-08, BE: 2026-01-30

Condition(s): Large B-cell Lymphoma
Product: RoActemra 20 mg/mL concentrate for solution for infusion, MabThera 500 mg concentrate for solution for infusion, Vincristine Sulfate 1 mg/ml solution for injection, Neulasta 6 mg solution for injection, AZD0486, RoActemra 20 mg/mL concentrate for solution for infusion, Truxima 500 mg concentrate for solution for infusion, Ribodoxo® 2 mg/ml Injektionslösung, Prednison 20 mg GALEN®, AZD0486, Endoxan 500 mg, poeder voor oplossing voor injectie, Ruxience 500 mg concentrate for solution for infusion

Primary endpoint: Safety Run in: Incidence and severity of AEs, SAEs, AESIs, and events of clinical interest;, Safety Run in: AEs/AEs leading to discontinuation or dose modification of AZD0486, Safety Run in: Clinically significant alterations in vital signs and abnormal laboratory parameters, Phase 3: PFS defined as the time from date of randomisation until disease progression as per Lugano 2014 as assessed by BICR, or death due to any cause
Endpoint(s): Safety Run in: ORR, CR Rate, DoR, DoCR, PFS, OS, Safety Run in: Concentration of AZD0486 in serum and PK parameters as data permits following R-mini-CHOP, Safety Run in: Summary of pre-existing and treatment induced ADAs for AZD0486 and the impact on PK, efficacy or safety, Phase 3: OS, Phase 3: ORR, CR rate, DoR, DoCR, PFS, PFS2, TFST, Phase 3: AEs, SAEs, AESIs, events of clinical interest, AEs leading to study treatment discontinuation or dose modification, Phase 3: Concentration of AZD0486 in serum and PK parameters as data permits following R-mini-CHOP, Phase 3: Summary of pre-existing and treatment induced ADAs for AZD0486 (positive or negative, titres) and the impact on PK, efficacy or safety, Phase 3: eCOA: - Proportion reporting different levels of pain and tirednesswhile on treatment using items from the FACT-LymS subsetfor all dosed participants, Phase 3: eCOA: - Proportion reporting each level of overall side effect bother on the PGI-TT, while on treatment for all dosed participants, Phase 3: eCOA: - Change from baseline on lymphoma-specific concerns based on FACT-LymS scores for all randomised participants, Phase 3: eCOA: - Change from baseline on overall HRQoL (based on QL2 item scores) for all randomised participants

Source: https://euclinicaltrials.eu/ctis-public/view/2025-522029-37-00